EU clinical trial 2024-515518-41-00: [14C]-BMS986504 Mass Balance Study in Patients with Advanced Solid Tumors with Homozygous MTAP Deletion
Protocol code: CA240-0008
Sponsor: Bristol-Myers Squibb Services Unlimited Company (Pharmaceutical company). Phase: Human Pharmacology (Phase I)- Other. Countries: Hungary (ongoing, recruiting), Spain (ongoing, recruiting).
Therapeutic area(s): Diseases [C] - Neoplasms [C04]
Gender: Female, Male. Age: 18-64 years, 65+ years. Enrolment: 16.
Status: Ongoing, recruiting. Start date (EU): 2025-03-24. Decision date: 2024-11-19. Results received: No. Last updated: 2026-07-14.
Decision dates by country: ES: 2026-02-02, HU: 2024-11-19

Condition(s): Advanced Solid Tumors

Source: https://euclinicaltrials.eu/ctis-public/view/2024-515518-41-00